EU clinical trial 2024-514611-98-00: A randomized phase III trial of trastuzumab + ALpelisib +/- fulvestrant versus trastuzumab + chemotherapy in patients with PIK3CA mutated previously treated HER2+ Advanced BrEasT cancer. “ALPHABET Study”
Sponsor: Fundacion Grupo Espanol De Investigacion En Cancer De Mama (Patient organisation/association). Phase: Therapeutic confirmatory (Phase III). Countries: Spain (ended).
Therapeutic area(s): Diseases [C] - Neoplasms [C04]
Gender: Female, Male. Age: 18-64 years, 65+ years. Enrolment: 27.
Status: Ended. Start date (EU): 2021-07-20. End date (EU): 2025-12-23. Decision date: 2024-10-24. Results received: No. Last updated: 2025-09-09.

Condition(s): PIK3CA mutated HER2+ advanced or relapsed breast cancer (BC) previously treated with trastuzumab
Product: ALPELISIB, ALPELISIB, ALPELISIB

Primary endpoint: PFS: Time from randomization to objective disease progression based on the investigator's assessment according to the response evaluation criteria for solid tumors (RECIST) version 1.1., or death from any cause.
Endpoint(s): OS: time from randomization to death from any cause., OR: complete or partial response as best overall response based on the investigator’s assessment according to RECIST version 1.1., Safety and tolerability: adverse events (AEs) grades will be defined by the National Cancer Institute common terminology criteria for adverse events (NCI-CTCAE) version 5.0. AE terms will be coded according to the MedDRA dictionary.

Source: https://euclinicaltrials.eu/ctis-public/view/2024-514611-98-00